EU clinical trial 2024-512773-27-00: An open label, balanced, randomized, two-treatment, two-period, two-sequence, single-dose, crossover, bioequivalence study comparing Upadacitinib Prolonged Release Tablets 15 mg, manufactured by Sun Pharmaceutical Industries Limited, India with RINVOQ 15 mg prolonged-release tablets (Upadacitinib), Marketing Authorization Holder: AbbVie Deutschland GmbH & Co. KG Knollstraße 67061 Ludwigshafen Germany, in healthy adult, human subjects under fasting condition.
Protocol code: UPADA-01-24
Sponsor: Sun Pharmaceutical Industries Limited (Pharmaceutical company). Phase: Human Pharmacology (Phase I)- Bioequivalence Study. Countries: Romania (ended).
Therapeutic area(s): Diseases [C] - Immune System Diseases [C20]
Gender: Female, Male. Age: 18-64 years. Enrolment: 54.
Status: Ended. Start date (EU): 2024-08-19. End date (EU): 2024-10-12. Decision date: 2024-07-15. Results received: No. Last updated: 2024-07-15.

Condition(s): Rheumatoid arthritis, ulcerative colitis, atopic dermatitis, Crohn's disease, psoriatic arthritis, axial spondyloarthritis

Source: https://euclinicaltrials.eu/ctis-public/view/2024-512773-27-00